EU clinical trial 2023-505661-89-00: A proof of concept study to evaluate treatments´efficacy by monitoring Minimal Residual Disease using ctDNA in HR-positive/HER2-negative early breast cancer population. -The MIRADOR study-
Protocol code: MedOPP485
Sponsor: Medica Scientia Innovation Research S.L. (Pharmaceutical company). Phase: Therapeutic exploratory (Phase II). Countries: Spain (ongoing, recruiting), France (ongoing, recruiting), Greece (ongoing, recruiting), Italy (ongoing, recruiting).
Therapeutic area(s): Diseases [C] - Neoplasms [C04]
Gender: Female, Male. Age: 18-64 years, 65+ years. Enrolment: 930.
Status: Ongoing, recruiting. Start date (EU): 2025-12-19. Decision date: 2024-04-09. Results received: No. Last updated: 2026-06-03.
Decision dates by country: FR: 2025-12-08, ES: 2024-04-09, IT: 2025-12-03, GR: 2025-11-17

Condition(s): Early-stage, Hormone Receptor (HR)-positive / Human Epidermal Growth Factor Receptor 2 (HER2)-negative, breast cancer (BC)
Product: Rx Abemaciclib Ramiven 150 mg 7x2 film coated tablets oral use, Rx Abemaciclib Ramiven 100 mg 7x2 film coated tablets oral use, RO7197597, Rx Abemaciclib Ramiven 50 mg 7x2 film coated tablets oral use, INAVOLISIB

Primary endpoint: Treatment phase: Proportion of participants with at least a 90% decrease or clearance in baseline ctDNA at three months after initiation of study treatment
Endpoint(s): Surveillance phase: Total ctDNA detection and breakdown by incidence at first ctDNA test versus incidence at subsequent ctDNA tests., Treatment phase: Proportion of participants with at least a 90% decrease in baseline ctDNA at six, nine, and 12 months after initiation of study treatment, Treatment phase: Proportion of participants with at least a 90% decrease in baseline ctDNA at three months maintained at six months and 12 months after initiation of study treatment., Treatment phase: Proportion of participants with 50% and 70% decrease in baseline ctDNA at three, six, nine, and 12 months after initiation of study treatment., Treatment phase: Time to rising ctDNA defined as time to first ctDNA increase compared to baseline, Treatment phase: Duration of at least a 90% decrease in baseline ctDNA after initiation of study treatment., Treatment phase: Best percentage of ctDNA decrease relative to baseline at six, nine, and 12 months after initiation of study treatment, Treatment phase: Safety and toxicity profile according to the NCI-CTCAE v.5.0., Evaluation of the primary and secondary outcomes based on the actual Study treatment received, including analyses within Arm A patients after switching treatment at month 3 and in the overall Study population. • Association of clinical outcomes, safety and/or tolerability profile with mutation profiling, copy number variability, gene expression, multiplex assays, proteomic analyses, digital pathology, immunohistochemistry, taxonomic o

Source: https://euclinicaltrials.eu/ctis-public/view/2023-505661-89-00